EU clinical trial 2024-516862-12-00: Study of hydroxocobalamin at a new concentration for cobalamin-related remethylation disorders.
Sponsor: Fundacion Instituto De Investigacion Sanitaria De Santiago De Compostela (Patient organisation/association). Phase: Phase II and Phase III (Integrated). Countries: Spain (authorised, recruitment pending).
Therapeutic area(s): Diseases [C] - Nutritional and Metabolic Diseases [C18]
Gender: Female, Male. Age: 0-17 years. Enrolment: 6.
Status: Authorised, recruitment pending. Decision date: 2025-06-09. Results received: No. Last updated: 2025-06-09.

Condition(s): Hydroxycobalamin deficiency
Product: COBALAMIN

Primary endpoint: measurement of tHcy blood concentration at baseline and at 3-, 6-, 9-, 12-, 12-, 15-, 18- and 24-month follow-up and comparison of concentrations in both treatment arms

Source: https://euclinicaltrials.eu/ctis-public/view/2024-516862-12-00